EU clinical trial 2024-515966-14-00: Nivolumab With Ipilimumab Combined With TGFβ-15 Peptide Vaccine and Radiotherapy for Pancreatic Cancer (CheckVAC)
Protocol code: PA 2217
Sponsor: Region Hovedstaden (Hospital/Clinic/Other health care facility). Phase: Human Pharmacology (Phase I)- First administration to humans. Countries: Denmark (ended).
Therapeutic area(s): Diseases [C] - Neoplasms [C04]
Gender: Female, Male. Age: 18-64 years, 65+ years. Enrolment: 20.
Status: Ended. Start date (EU): 2023-05-03. End date (EU): 2026-03-16. Decision date: 2024-09-13. Results received: No. Last updated: 2025-11-26.

Condition(s): advanced pancreatic cancer

Source: https://euclinicaltrials.eu/ctis-public/view/2024-515966-14-00